EU clinical trial 2023-510465-10-00: A parallel-group prevention, Phase II, partially blinded, multi-stage study to investigate the immunogenicity and safety of Pentavalent Meningococcal ABCYW Vaccine formulations compared with licensed meningococcal vaccines when administered alone in healthy children (2 to 9 years of age) or concomitantly with routine pediatric vaccines in toddlers (12 to 15 months of age) and infants (2 months of age).
Protocol code: VAN00013
Sponsor: Sanofi Pasteur Inc. (Pharmaceutical company). Phase: Therapeutic exploratory (Phase II). Countries: Poland (ongoing, recruitment ended), Finland (ended), Spain (ongoing, recruitment ended), Denmark (ended), Czechia (ongoing, recruitment ended), Germany (ongoing, recruitment ended).
Therapeutic area(s): Diseases [C] - Bacterial Infections and Mycoses [C01]
Gender: Female, Male. Age: 0-17 years. Enrolment: 250.
Start date (EU): 2025-03-10. Decision date: 2025-01-21. Results received: No. Last updated: 2026-06-25.
Decision dates by country: CZ: 2025-01-22, FI: 2025-01-23, ES: 2025-01-21, DK: 2025-01-22, PL: 2025-01-27, DE: 2025-01-24

Condition(s): Meningococcal immunization
Product: Nimenrix powder and solvent for solution for injection in pre-filled syringe Meningococcal groups A, C, W-135 and Y conjugate vaccine, Hexyon suspension for injection in pre-filled syringe Diphtheria, tetanus, pertussis (acellular, component), hepatitis B (rDNA), poliomyelitis (inactivated) and Haemophilus influenzae type b conjugate vaccine (adsorbed)., Prevenar 13 suspension for injection pneumococcal polysaccharide conjugate vaccine (13-valent, adsorbed), MenQuadfi solution for injection Meningococcal Group A, C, W and Y conjugate vaccine, RotaTeq oral solution Rotavirus vaccine (live), MenPenta SD, MenPenta fHD, Bexsero suspension for injection in pre-filled syringe Meningococcal group B Vaccine (rDNA, component, adsorbed)

Primary endpoint: Number of participants with unsolicited immediate adverse events (AEs), Number of participants with solicited injection site reactions or systemic reactions, Number of participants with unsolicited AEs, Number of participants with serious adverse events (SAEs), hSBA meningococcal serogroups A, C, W, and Y antibody titers pre-dose and 30 days after the second and third dose in infant participants, hSBA meningococcal serogroups A, C, W, and Y vaccine seroresponse pre-dose and 1 month after the second and third dose in infant participants, Geometric mean titers (GMTs) of Antibodies against Meningococcal Serogroups A, C, W and Y pre-dose and 1 month after the second and third dose in infant participants, Percentage of participants with hSBA titers more or equal to lower limit of quantification (LLOQ) against each of serogroups A, C, W, and Y pre-dose and 1 month after the second and third dose in infant participants, Percentage of Participants With Meningococcal Antibody Titers against meningococcal serogroup B (reference MenB strains) ≥ 1:4 pre-dose and 1 month after the second dose of vaccination against serogroup B, before and 30 days after third dose in infant participants, Percentage of Participants With Meningococcal Antibody Titers against meningococcal serogroup B (reference MenB strains) ≥ 1:8 pre-dose and 1 month after the second dose of vaccination against serogroup B, before and 30 days after third dose in infant participants, hSBA meningococcal serogroup B seroresponse pre-dose and 1 month after the second dose of vaccination against serogroup B, before and 30 days after third dose in infant participants, Geometric mean titers (GMTs) of Antibodies against Meningococcal Serogroup B (reference MenB strains) pre-dose and 1 month after the second dose of vaccination against serogroup B, before and 30 days after third dose in infant participants, Percentage of participants with hSBA titers more or equal to lower limit of quantification (LLOQ) against each and all of serogroup B (reference MenB strains) pre-dose and 1 month after the second dose of vaccination against serogroup B, before and 30 days after third dose in infant participants, Percentage of participants with hSBA titers less than the lower limit of quantification (LLOQ) against all serogroup B (reference MenB strains) pre-dose and 1 month after the second dose of vaccination against serogroup B, before and 30 days after third dose in infant participants, hSBA meningococcal serogroups A, C, W, and Y antibody titers in children and toddlers, hSBA meningococcal serogroups A, C, W, and Y vaccine seroresponse in children and toddlers, Geometric mean titers (GMTs) of Antibodies against Meningococcal Serogroups A, C, W and Y pre-dose and 1 month after the second dose children and toddlers, Percentage of participants with hSBA titers more or equal to lower limit of quantification (LLOQ) against each of serogroups A, C, W, and Y children and toddlers, Percentage of Participants With Meningococcal Antibody Titers against meningococcal serogroup B (reference MenB strains) ≥ 1:4 in children and toddlers, Percentage of Participants With Meningococcal Antibody Titers against meningococcal serogroup B (reference MenB strains) ≥ 1:8 in children and toddlers, hSBA meningococcal serogroup B (reference MenB strains) vaccine seroresponse in children and toddlers, Geometric mean titers (GMTs) of Antibodies against Meningococcal Serogroup B (reference MenB strains) in children and toddlers, Percentage of participants with hSBA titers more or equal to lower limit of quantification (LLOQ) against each and all of serogroup B (reference MenB strains) in children and toddlers, Percentage of participants with hSBA titers less than the lower limit of quantification (LLOQ) against all serogroup B (reference MenB strains) in children and toddlers
Endpoint(s): hSBA meningococcal serogroup B (additional MenB strains) vaccine seroresponse in children, toddler and infant participants, Percentage of Participants With Meningococcal Antibody Titers against meningococcal serogroup B (additional MenB strains) ≥ 1:4 in children, toddler and infant participants, Percentage of Participants With Meningococcal Antibody Titers against meningococcal serogroup B (additional MenB strains) ≥ 1:8 in children, toddler and infant participants, Geometric mean titers (GMTs) of Antibodies against Meningococcal Serogroup B (additional MenB strains) in children, toddler and infant participants, Percentage of participants with hSBA composite seroresponse titers more or equal to LLOQ each and all additional MenB strains in children, toddler and infant participants, Percentage of participants with hSBA composite seroresponse titers less than LLOQ all additional MenB strains in children, toddler and infant participants

Source: https://euclinicaltrials.eu/ctis-public/view/2023-510465-10-00